EU clinical trial 2023-508441-41-00: Efficacy and safety of 7 versus 14 days of antibiotic treatment for bacteremia produced by Pseudomonas aeruginosa: a multicenter, randomized (SHORTEN-2) clinical trial with a DOOR/RADAR analysis.
Protocol code: SHORTEN-II
Sponsor: Fundacion Publica Andaluza Para La Gestion De La Investigacion En Salud De Sevilla (Laboratory/Research/Testing facility). Phase: Therapeutic use (Phase IV). Countries: Spain (ended).
Therapeutic area(s): Diseases [C] - Bacterial Infections and Mycoses [C01]
Gender: Female, Male. Age: 18-64 years, 65+ years. Enrolment: 306.
Status: Ended. Start date (EU): 2024-07-08. End date (EU): 2025-12-01. Decision date: 2024-07-08. Results received: No. Last updated: 2025-07-25.

Condition(s): Bacteriemia producida por P. aeruginosa.
Product: Zerbaxa 1 g/0.5 g powder for concentrate for solution for infusion, Azactam 1g polvo para solución inyectable, Ceftazidima SALA 1.000 mg polvo para solución para perfusión EFG, Meropenem Qilu 1 g polvo para solución inyectable y para perfusión EFG, Colistimetato de sodio Accord 2 millones de UI polvo para solución inyectable y para perfusión EFG, Zerbaxa 1 g/0.5 g powder for concentrate for solution for infusion, MEROPENEM QILU 1 g, poudre pour solution injectable/pour perfusion, Quofenix 300 mg powder for concentrate for solution for infusion, CIPROFLOXACINO KABI 2 mg/ml solución para perfusion, Fetcroja 1 g powder for concentrate for solution for infusion, Quofenix 450 mg tablets, Fetcroja 1 g powder for concentrate for solution for infusion, Imipenem/Cilastatina Aurovitas 500 mg/500 mg polvo para solución para perfusión EFG, Imipenem/Cilastatina Kabi 500/500 mg, polvo para solución para perfusión , ciprofloxacino cinfa 750 mg comprimidos recubiertos EFG, Tobramicina NORMON 100 mg/2 ml solución inyectable EFG, CEFEPIME ACCORD 1 g, poudre pour solution injectable/pour perfusion (IM/IV), Zavicefta 2 g/0.5 g powder for concentrate for solution for infusion, Amicacina Braun 500 mg Solución inyectable, Levofloxacino Kabi 5 mg/ml solución para perfusión., LEVOFLOXACINO NORMON 500 mg Comprimidos recubiertos con película EFG., Vaborem 1 g/1 g powder for concentrate for solution for infusion, AMIKACINE B. BRAUN 2,5 mg/ml, solution pour perfusion, Colistimetato de sodio Altan Pharma 2 millones de UI polvo para solución inyectable y para perfusión, Cefepima Accord 1 g polvo para solución inyectable y para perfusión EFG, Azactam 1 g Powder for Solution for Injection or Infusion, Tobramicina NORMON 50 mg/2 ml solución inyectable EFG, CIPROFLOXACINO KABI 2 mg/ml solución para perfusión, Vaborem 1 g/1 g powder for concentrate for solution for infusion, Ceftazidima Sala 1.000 mg polvo para solución inyectable EFG, Quofenix 450 mg tablets, Piperacilina/Tazobactam Accord 4 g/0,5 g polvo para solución para perfusión EFG, MONOFLOX 500 mg comprimidos recubiertos con película EFG, Ciprofloxacino Aurovitas 750 mg comprimidos recubiertos con película EFG, Quofenix 300 mg powder for concentrate for solution for infusion, Zavicefta 2 g/0.5 g powder for concentrate for solution for infusion, Levofloxacino Netpharmalab 5mg/ml solución para perfusión EFG, Piperacilina/Tazobactam Sala 4 g/0,5 g polvo para solución para perfusión EFG

Primary endpoint: Days of antibiotic treatment and DOOR scale category (Desirability of Outcome Ranking) at the end of follow-up: Day +30 after the end of aproppriate antibiotic treatment.
Endpoint(s): All-cause mortality, clinical cure and treatment failure: Days +30 and +90 after the end of aproppriate antibiotic treatment., Superinfections, serious adverse events, days of hospital stay, and recurrences (proven, probable or possible): Day +90 after the end of aproppriate antibiotic treatment.

Source: https://euclinicaltrials.eu/ctis-public/view/2023-508441-41-00